EU clinical trial 2024-517712-29-00: A Dose-Finding, Adaptive, Randomized, Double-Blinded, Placebo-Controlled Trial to Evaluate the Safety, Tolerability, and Efficacy of TAK-360 in Participants with Idiopathic Hypersomnia (IH)
Protocol code: TAK-360-2002
Sponsor: Takeda Development Center Americas Inc. (Pharmaceutical company). Phase: Therapeutic exploratory (Phase II). Countries: Italy (ongoing, recruiting), France (ongoing, recruiting), Spain (ongoing, recruiting).
Therapeutic area(s): Diseases [C] - Nervous System Diseases [C10]
Gender: Female, Male. Age: 18-64 years, 65+ years. Enrolment: 53.
Status: Ongoing, recruiting. Start date (EU): 2025-05-27. Decision date: 2025-05-06. Results received: No. Last updated: 2026-07-09.
Decision dates by country: ES: 2025-05-06, FR: 2025-05-09, IT: 2025-05-07

Condition(s): Idiopathic Hypersomnia (IH)

Primary endpoint: Occurrence of at least 1 treatment-emergent adverse event (TEAE) during the trial.
Endpoint(s): Change from baseline at Week 4 in ESS total score, as compared to placebo., Change from baseline at Week 4 in IHSS total score, as compared to placebo.

Source: https://euclinicaltrials.eu/ctis-public/view/2024-517712-29-00